EU clinical trial 2023-504433-50-00: Trans-arterial treatment of patients with intra-hepatic cholangiocarcinoma not amenable to resection (TOMCAT)
Sponsor: Oslo University Hospital HF (Hospital/Clinic/Other health care facility). Phase: Therapeutic use (Phase IV). Countries: Norway (ongoing, recruiting).
Therapeutic area(s): Diseases [C] - Neoplasms [C04]
Gender: Female, Male. Age: 18-64 years, 65+ years. Enrolment: 800.
Status: Ongoing, recruiting. Start date (EU): 2024-01-05. Decision date: 2023-11-16. Results received: No. Last updated: 2026-02-09.

Condition(s): Intra-hepatic cholangiocarcinoma
Product: DEXAMETHASONE SODIUM PHOSPHATE, GEMCITABINE HYDROCHLORIDE, Floxuridine, HEPARIN, OXALIPLATIN

Primary endpoint: Median survival time
Endpoint(s): Proportion of patients surviving 1 year, 2 years, Tumour response rate (CT scans, RECIST 1.1) (best response registered at any time): Proportion of patients with Partial Response, proportion of patients with Stable Disease, duration of Stable Disease and proportion of patients converted to resectability following downstaging, Change in HR-QoL (EORTC QLQ-C30 and EQ-5D-5L) from baseline to end-of-treatment, Change in ctDNA from baseline to end-of-treatment, Assess circulating cell-free DNA (ctDNA) before and after treatment and correlate with treatment outcomes, Evaluate tumour heterogeneity, based on whole exome sequencing of multiple tumour biopsies obtained at surgery for pump placement or during laparoscopic staging. The genomic findings will be used to stratify patients with respect to response and survival, and will also be used to quantify the degree of tumour heterogeneity., ctDNA and tumour genomic heterogeneity results will be further correlated with texture variables extracted from pre-treatment, contrast-enhanced CT scans.

Source: https://euclinicaltrials.eu/ctis-public/view/2023-504433-50-00